EU clinical trial 2025-523777-41-01: Morphine PCA vs Morphine and Lidocaine PCA for the treatment of vaso-occlusive crisis-related pain in sickle-cell anaemia patients: a prospective, randomized, double blind monocentric trial.
Sponsor: CHU Saint Pierre (Hospital/Clinic/Other health care facility). Phase: Therapeutic use (Phase IV). Countries: Belgium (authorised, recruiting).
Therapeutic area(s): Diseases [C] - Congenital, Hereditary, and Neonatal Diseases and Abnormalities [C16]
Gender: Female, Male. Age: 18-64 years, 65+ years. Enrolment: 40.
Status: Authorised, recruiting. Start date (EU): 2026-08-07. Decision date: 2026-01-26. Results received: No. Last updated: 2026-01-26.

Condition(s): sickle cell anaemia
Product: LIDOCAINE HYDROCHLORIDE, MORPHINE HYDROCHLORIDE

Primary endpoint: Reduction in morphine consumption
Endpoint(s): Evolution of biomarkers, Evolution of pain scores using the VAS score, Occurence of morphine-related adverse effects

Source: https://euclinicaltrials.eu/ctis-public/view/2025-523777-41-01